EU clinical trial 2024-518812-38-00: Phase II clinical trial with an adaptive design according to response to cemiplimab monotherapy using ctDNA and subsequent treatment with chemotherapy (CT) and cemiplimab or cemiplimab monotherapy in first line advanced NSCLC patients. PALACE GECP 22/01
Protocol code: PALACE _GECP 22/01
Sponsor: Fundacion GECP (Patient organisation/association). Phase: Therapeutic exploratory (Phase II). Countries: Spain (ongoing, recruiting).
Therapeutic area(s): Diseases [C] - Neoplasms [C04]
Gender: Female, Male. Age: 18-64 years, 65+ years. Enrolment: 63.
Status: Ongoing, recruiting. Start date (EU): 2025-07-02. Decision date: 2025-03-26. Results received: No. Last updated: 2026-06-29.

Condition(s): Non-small cell lung cancer (NSCLC)
Product: Paclitaxel Teva 6 mg/ml concentrado para solución para perfusión EFG, LIBTAYO 350 mg concentrate for solution for infusion., Pemetrexed Stadagen 25 mg/ml concentrado para solución para perfusion, Carboplatino Teva 10 mg/ml Concentrado para solución para perfusión

Primary endpoint: OS at 24 months in the intention to treat (ITT) population
Endpoint(s): 1. Duration of response (DOR), 2. Overall survival (OS) at 12, 36 and 48 months, 3. Progression free survival (PFS) at 12, 24, 36 and 48 months, 4. Sites of first failure, 5. Overall response rate (ORR), 6. Toxicity profile

Source: https://euclinicaltrials.eu/ctis-public/view/2024-518812-38-00